EU clinical trial 2024-512472-35-00: Evaluation of safety and pharmacokinetic parameters of the PTI5803 product
Sponsor: Panntherapi, Eurofins Optimed (Pharmaceutical company). Phase: Human Pharmacology (Phase I)- Other. Countries: France (ended).
Therapeutic area(s): Diseases [C] - Nervous System Diseases [C10]
Gender: Female, Male. Age: 18-64 years. Enrolment: 8.
Status: Ended. Start date (EU): 2024-07-23. End date (EU): 2024-10-28. Decision date: 2024-07-08. Results received: No. Last updated: 2024-09-23.

Condition(s): Epilepsy

Source: https://euclinicaltrials.eu/ctis-public/view/2024-512472-35-00